EU clinical trial 2024-518072-31-00: Phase 2b, Randomized, Double-Blind, Placebo-Controlled Clinical Trial, Preceded by a Single Ascending Dose Portion and a Phase 2 Open-Label Portion, to Evaluate the Safety and Efficacy of Oral Infigratinib in Infants and Young Children with Achondroplasia
Protocol code: QBGJ398-204
Sponsor: Qed Therapeutics Inc. (Pharmaceutical company). Phase: Therapeutic exploratory (Phase II). Countries: Spain (authorised, recruiting), Norway (ongoing, recruiting).
Therapeutic area(s): Diseases [C] - Congenital, Hereditary, and Neonatal Diseases and Abnormalities [C16]; Diseases [C] - Musculoskeletal Diseases [C05]
Gender: Female, Male. Age: 0-17 years. Enrolment: 11.
Start date (EU): 2026-01-27. Decision date: 2025-12-10. Results received: No. Last updated: 2026-01-16.
Decision dates by country: NO: 2025-12-11, ES: 2025-12-10

Condition(s): Achondroplasia
Product: INFIGRATINIB, INFIGRATINIB, INFIGRATINIB

Primary endpoint: SAD: Safety., SAD: PK of infigratinib and its active metabolites., Ph2: Safety: TEAEs that lead to dose decrease or discontinuation., PH2: PK of infigratinib and its active metabolites., Ph2b: AEs, SAEs, including clinically significant changes in: vital signs, laboratory assessments, physical examination (including fontanelles closure when applicable), ECG, imaging (including bone abnormalities not common in ACH), laboratory test results (including hyperphosphatemia), ocular events, abnormalities in teeth formation and eruption; delays in developmental milestones based on milestone charts for ACH (Ireland 2010)., Ph2b: Change from BL to Week 52 in body length Z-score in relation to ACH tables. - BL corresponds to the body length Z-score at Day 1., Extension: AEs, SAEs, including clinically significant changes in: vital signs, physical examination (including fontanelles closure when applicable), ECG, imaging (including bone abnormalities not common in ACH), laboratory test results (including hyperphosphatemia), ocular events, abnormalities in teeth formation and eruption; delays in developmental milestones based on milestone charts for ACH (Ireland 2010)., Extension: Change over time in body length Z-score in relation to ACH tables.
Endpoint(s): Ph2: AEs, SAEs, including clinically significant changes in: vital signs, laboratory assessments, physical examination (including fontanelles closure when applicable), ECG, imaging (including bone abnormalities not common in ACH), laboratory test results (including hyperphosphatemia), ocular events, abnormalities in teeth formation and eruption; delays in developmental milestones based on milestone charts for ACH (Ireland 2010)., Ph2: Mean and change from BL in body length Z-score at Week 52 (in relation to ACH tables; BL: values at Day 1)., Ph2: Mean and change from BL to Week 52 in upper- to lower-body segment ratio., Ph2: Mean and change from BL to Week 52 in head circumference/body length ratio., Ph2: Health-related quality of life using Infant Toddler Quality of Life (ITQoL)., Ph2: Milestone development, including social/emotional, language/communication; cognitive; movement/physical development and specific movement strategies used by children with ACH (Ireland 2010)., Ph2: Skull and brain morphology using magnetic resonance imaging (MRI)., Ph2: Age at closure of cranial sutures and fontanelles., Ph2: Incidence of surgical interventions, including cervical decompression, adenotonsillectomy, and tympanostomy., Ph2: Incidence and severity of sleep apnea., Ph2: Bone morphology as assessed by bilateral x-rays of lower extremity and whole spine., Ph2b: Body length Z-score at Week 52 in relation to ACH tables., Ph2b: Mean and change from BL to Week 52 in upper-to lower-body segment ratio., Ph2b: Mean and change from BL in head circumference/body length ratio., Ph2b: PK of infigratinib and its active metabolites., Ph2b: Health-related quality of life using ITQoL., Ph2b: Milestone development, including social/emotional, language/communication; cognitive; movement/physical development and specific movement strategies used by children with ACH (Ireland 2010)., Ph2b: Skull and brain morphology using MRI., Ph2b: Age at closure of cranial sutures and fontanelles., Ph2b: Incidence of surgical interventions, including but not limited to adenotonsillectomy, and tympanostomy., Ph2b: Incidence and severity of sleep apnea., Ph2b: Bone morphology as assessed by bilateral x-rays of lower extremities and whole spine., Extension: Change over time in upper- to lower-body segment ratio., Extension: Change over time in head circumference/body length ratio., Extension: Health-related quality of life using ITQoL., Extension: Milestone development, including social/emotional, language/communication; cognitive; movement/physical development and specific movement strategies used by children with ACH (Ireland 2010)., Extension: Age at closure of cranial sutures and fontanelles., Extension: Incidence of surgical interventions, including cervical decompression, adenotonsillectomy, and tympanostomy., Extension: Bone morphology as assessed by bilateral x-rays of lower extremity and whole spine.

Source: https://euclinicaltrials.eu/ctis-public/view/2024-518072-31-00